EU clinical trial 2024-517016-30-00: A Phase 2, multicenter, randomized, double-blind, placebo controlled, dose-ranging study to evaluate the efficacy and safety of brivekimig in adults with moderate to severe Crohn’s disease
Protocol code: DRI18450
Sponsor: Sanofi-Aventis Recherche & Developpement (Pharmaceutical company). Phase: Therapeutic exploratory (Phase II). Countries: Spain (ongoing, recruiting), Czechia (ongoing, recruiting), Belgium (ongoing, recruiting), Germany (authorised, recruiting), France (ongoing, recruiting), Poland (ongoing, recruiting).
Therapeutic area(s): Diseases [C] - Digestive System Diseases [C06]
Gender: Female, Male. Age: 18-64 years, 65+ years. Enrolment: 30.
Start date (EU): 2025-09-26. Decision date: 2025-08-04. Results received: No. Last updated: 2026-07-16.
Decision dates by country: BE: 2025-08-05, FR: 2025-08-04, ES: 2025-08-08, PL: 2025-08-11, CZ: 2025-08-05, DE: 2025-08-11

Condition(s): Crohn’s disease
Product: SAR442970, NANOBODY® Placebo; The placebo is a standard placebo formulation containing common excipients for NANOBODY drug products and is used by Sanofi for NANOBODY clinical studies.

Primary endpoint: Percentage of participants who achieve endoscopic response at Week 16. Endoscopic response is defined as decrease in SES-CD >50% from baseline (or a decrease of at least 2 points for subjects with a baseline score of 4 or more and isolated ileal disease) based on central reading.
Endpoint(s): Percentage of participants who achieve clinical remission based on CDAI at Week 16. CDAI clinical remission is defined as CDAI score <150., Percentage of participants who achieve PRO-2 clinical remission at Week 16. PRO-2 clinical remission is defined as using the average daily SF ≤3 and not worse than baseline and average daily AP ≤1 and not worse than baseline., Percentage of participants who achieve endoscopic remission at Week 16. Endoscopic remission is defined as SES-CD ≤4 and at least 2 point reduction versus baseline and no subscore >1 in any individual variable based on central reading., Percentage of participants who achieve at Week 16 both clinical remission based on CDAI score and endoscopic response based on SES-CD., Percentage of participants who achieve CDAI clinical response at Week 16. CDAI clinical response is defined as reduction of CDAI ≥100 points from baseline., Change from baseline in the IBDQ score at Week 16., Change from baseline in FACIT-F score at Week 16., On-treatment serum concentrations of brivekimig at predefined timepoints., Number and percentage of participants with any TEAEs during induction and maintenance and LTE treatment period., Number and percentage of participants with any TEAEs during open-label treatment period., Incidence of ADAs over time., Percentage of participants who achieve endoscopic remission based on centrally read SES-CD at Week 52., Percentage of participants who achieve endoscopic response at Week 52.

Source: https://euclinicaltrials.eu/ctis-public/view/2024-517016-30-00